EU clinical trial 2024-520418-22-00: A randomized, double-blind, placebo-controlled, parallel-group, multicenter study of the efficacy and safety of depemokimab in adult participants with COPD with Type 2 inflammation.
Protocol code: 222714
Sponsor: Glaxosmithkline Research & Development Limited (Pharmaceutical company). Phase: Therapeutic confirmatory (Phase III). Countries: Slovakia (ongoing, recruiting), Denmark (ongoing, recruiting), France (ongoing, recruiting), Sweden (ongoing, recruiting), Ireland (ongoing, recruiting), Belgium (ongoing, recruiting), Netherlands (ongoing, recruiting), Spain (ongoing, recruiting), Croatia (ongoing, recruiting), Germany (ongoing, recruiting), Poland (ongoing, recruiting), Hungary (ongoing, recruiting), Norway (ongoing, recruiting), Portugal (ongoing, recruiting).
Therapeutic area(s): Diseases [C] - Respiratory Tract Diseases [C08]
Gender: Female, Male. Age: 18-64 years, 65+ years. Enrolment: 453.
Status: Ongoing, recruiting. Start date (EU): 2026-01-20. Decision date: 2025-11-24. Results received: No. Last updated: 2026-07-22.
Decision dates by country: SK: 2025-11-24, DK: 2025-11-24, HR: 2025-12-01, IE: 2025-11-28, PT: 2026-02-20, NO: 2025-11-28, HU: 2025-12-01, SE: 2025-11-24, ES: 2025-11-27, BE: 2025-11-26, DE: 2026-02-10, NL: 2025-12-01, FR: 2025-11-24, PL: 2026-02-22

Condition(s): Chronic Obstructive Pulmonary Disease
Product: Novolizer Salbutamol 100 microgrammes/dose, poudre pour inhalation, Sterile 0.9% (w/v) sodium chloride solution in single-use PFS

Primary endpoint: Annualized rate of moderate/severe exacerbations.
Endpoint(s): 1. Time to first moderate/severe exacerbation., 2. Change from baseline in St. George's Respiratory Questionnaire (SGRQ) total score at Week 52., 3. Change from baseline in Evaluating Respiratory Symptoms in Chronic Obstructive Pulmonary Disease (E-RS: COPD) total score at Week 52., 4. Annualized Rate of Exacerbations Requiring Emergency Department (ED) Visit or Hospitalization, 5. Annualized Rate of Severe Exacerbations

Source: https://euclinicaltrials.eu/ctis-public/view/2024-520418-22-00